EU clinical trial 2023-503502-37-00: A Phase 2a, Multicenter, Randomized, Double-blind, Placebo-controlled Study to Evaluate the Efficacy and Safety of MK-6194 in Adult Participants with Non-Segmental Vitiligo.
Protocol code: MK-6194-007
Sponsor: Merck Sharp & Dohme LLC (Pharmaceutical company). Phase: Therapeutic exploratory (Phase II). Countries: Belgium (ended), Germany (ended), Spain (ended), France (ended), Netherlands (ended).
Therapeutic area(s): Diseases [C] - Immune System Diseases [C20]
Gender: Female, Male. Age: 18-64 years, 65+ years. Enrolment: 33.
Status: Ended. Start date (EU): 2024-01-24. End date (EU): 2025-06-30. Decision date: 2023-12-22. Results received: Yes. Last updated: 2026-07-07.
Decision dates by country: NL: 2023-12-28, FR: 2024-01-09, DE: 2023-12-28, ES: 2023-12-22, BE: 2024-01-08

Condition(s): Non segmental vitiligo
Product: Placebo to MK-6194, MK-6194

Primary endpoint: Change from Baseline in Facial Vitiligo Area Scoring Index (F-VASI) at Week 24, Number of Participants Who Experience an Adverse Event (AE), Number of Participants Who Discontinue Study Treatment Due to an AE
Endpoint(s): Change from Baseline in Total Vitiligo Area Scoring Index (T-VASI) at Week 24

Source: https://euclinicaltrials.eu/ctis-public/view/2023-503502-37-00